EU clinical trial 2023-504339-41-00: A Phase 3 Randomized, Double-Blind, Placebo-Controlled Study Evaluating the Efficacy and Safety of Dose-Titrated PLS240 in the Treatment of Secondary Hyperparathyroidism in Individuals with End Stage Kidney Disease on Hemodialysis (PATH-2) With an Open-Label Extension
Protocol code: PP3003
Sponsor: Pathalys Pharma Inc. (Pharmaceutical company). Phase: Therapeutic confirmatory (Phase III). Countries: Portugal (ended), Bulgaria (ended), Spain (ended), Poland (ended).
Therapeutic area(s): Diseases [C] - Female Urogenital Diseases and Pregnancy Complications [C13]; Diseases [C] - Hormonal diseases [C19]; Diseases [C] - Male Urogenital Diseases [C12]
Gender: Female, Male. Age: 18-64 years, 65+ years. Enrolment: 100.
Status: Ended. Start date (EU): 2023-11-08. End date (EU): 2025-06-30. End date: 2025-07-31. Decision date: 2023-09-25. Results received: No. Last updated: 2025-06-16.
Decision dates by country: ES: 2023-09-25, PL: 2023-10-02, BG: 2023-10-02, PT: 2023-09-27

Condition(s): ESKD participants with history of secondary hyperparathyroidism (SHPT) undergoing maintenance hemodialysis
Product: PLS240, PLS240, PLS240, Excipients without active substance, PLS240, PLS240, PLS240, PLS240

Primary endpoint: Double-Blind Phase The proportion of participants with a ≥30% decrease in mean iPTH during the Efficacy Assessment Period (EAP, Weeks 22 - 27) relative to the mean baseline iPTH (all Active Screening and predose Day 1 iPTH values)., Open-Label Phase • Safety clinical laboratory tests, vital signs, ECG, AEs, and physical exams, Open-Label Phase • Proportion of participants with a cCa <7.5 mg/dL, and the proportion of participants with a cCa <8.3 mg/dL
Endpoint(s): • The proportion of participants with a ≥50% decrease in mean iPTH during the EAP (Weeks 22 - 27) relative to the mean baseline iPTH (all Active Screening and predose Day 1 iPTH values), • The proportion of participants with a mean iPTH during the EAP (Weeks 22 - 27) ≥150 pg/mL but ≤300 pg/mL., • The percentage change from baseline in iPTH during the course of the study (weekly iPTH values)., • The absolute and percentage changes in serum cCa and serum P levels and their mathematical product, •The proportion of participants who did not have an increase in Active Vitamin D sterol dose during the double blind phase with a ≥30% reduction in mean iPTH during the EAP relative to mean baseline iPTH., • Cmax and AUC as data permit., • Removal rate by dialysis., • Safety clinical laboratory tests, ECGs, vital signs, AEs, AEs leading to modification of dose or frequency of calcium supplements or phosphate binders, and physical exams, • Proportion of participants with a cCa <7.5 mg/dL, and proportion of participants with a cCa <8.3 mg/dL

Source: https://euclinicaltrials.eu/ctis-public/view/2023-504339-41-00